EU clinical trial 2024-513931-26-00: Multicenter phase II study of preoperative chemoradiotherapy with CApecitabine plus Temozolomide in patients with MGMT silenced and microsatellite stable locally Advanced RecTal Cancer: the CATARTIC trial
Sponsor: Fondazione IRCCS Istituto Nazionale Dei Tumori (Hospital/Clinic/Other health care facility). Phase: Therapeutic exploratory (Phase II). Countries: Italy (ongoing, recruiting).
Therapeutic area(s): Diseases [C] - Neoplasms [C04]
Gender: Female, Male. Age: 18-64 years, 65+ years. Enrolment: 21.
Status: Ongoing, recruiting. Start date (EU): 2021-12-01. Decision date: 2024-08-05. Results received: No. Last updated: 2024-08-05.

Condition(s): locally advanced rectal cancer (LARC)
Product: TEMOZOLOMIDE, TEMOZOLOMIDE, CAPECITABINE

Primary endpoint: Pathologic complete response (pCR), defined as complete histological regression with no available tumor cells (yT0N0) in the intention-to-treat population
Endpoint(s): R0 resection rate (defined as the rate of microscopically margin-negative resections), Tumor downstaging rate (defined as the rate of reduction in the stage of the tumor as a result of therapy, from a more to a less threatening stage), Sphincter preservation rate (defined as the percentage of patients with preserved anorectal sphincter after surgery), Local recurrence rate (defined as the rate of detectable local disease at follow-up after study treatment completion), disease-free survival, overall survival

Source: https://euclinicaltrials.eu/ctis-public/view/2024-513931-26-00